EU clinical trial 2024-512413-40-00: Long-term study evaluating the effect of givinostat in patients with JAK2V617F positive chronic myeloproliferative neoplasms
Protocol code: DSC/11/2357/44
Sponsor: Italfarmaco S.p.A. (Pharmaceutical company). Phase: Therapeutic exploratory (Phase II). Countries: Italy (ongoing, recruitment ended).
Therapeutic area(s): Diseases [C] - Hemic and Lymphatic Diseases [C15]
Gender: Female, Male. Age: 18-64 years, 65+ years. Enrolment: 48.
Status: Ongoing, recruitment ended. Start date (EU): 2013-03-08. Decision date: 2024-06-25. Results received: No. Last updated: 2026-04-29.

Condition(s): Chronic myeloproliferative neoplasm
Product: Givinostat 75 mg capsules, Givinostat 100 mg capsules, Givinostat 50 mg capsules

Primary endpoint: Long term safety and tolerability • Number of patients experience adverse events • Type, incidence, and severity of treatment-related adverse events, graded according to the latest available version of Common Terminology Criteria for Adverse Events (CTCAE)., Long term efficacy • For PV and ET: Complete response (CR) and partial response (PR) rate according to the revised clinicl-haematological European LeukemiaNet (ELN) response criteria • For MF: complete response, major response, moderate response and minor response rate according to European Myelofibrosis Network (EUMNET) response criteria. Please refer to the protocol for the full details
Endpoint(s): The effect of givinostat on each single response parameter according to the revised ELN (For PV and ET) and EUMNET response criteria (for MF), Reduction of the JAK2v617F allele burden by quantitative RT-PCR, Identification of potential other markers predictive of clinical benefit of givinostat (e.g. potential PD markers)., Evaluation of the parameters that allows to evaluate the disease evolution and history (e.g. thrombotic rate, PFS etc.).

Source: https://euclinicaltrials.eu/ctis-public/view/2024-512413-40-00